EU clinical trial 2024-517406-29-00: A trial of prednisolone in combination with SPI-62 or placebo in participants with polymyalgia rheumatica (PMR)
Protocol code: SPI-62-CL-2003
Sponsor: Sparrow Pharmaceuticals Inc. (Pharmaceutical company). Phase: Therapeutic exploratory (Phase II). Countries: Germany (ended), Poland (ended).
Therapeutic area(s): Diseases [C] - Musculoskeletal Diseases [C05]
Gender: Female, Male. Age: 18-64 years, 65+ years. Enrolment: 72.
Status: Ended. Start date (EU): 2022-07-26. End date (EU): 2025-04-25. Decision date: 2024-11-05. Results received: No. Last updated: 2025-02-14.
Decision dates by country: DE: 2024-11-05, PL: 2024-11-07

Condition(s): Polymyalgia rheumatica (PMR)
Product: Prednisolon 5 mg JENAPHARM, SPI-62_DF2, Capsule, hard for oral use as placebo for prednisolone., Film-coated tablet for oral use as placebo for Clofutriben (SPI-62)., SPI-62_DF1

Primary endpoint: Fibrinogen, erythrocyte sedimentation ratio, C-reactive protein
Endpoint(s): Oral glucose tolerance test glucose area under the concentration‑time curve, osteocalcin, urinary 11β-hydroxysteroid dehydrogenase type 1 ratio

Source: https://euclinicaltrials.eu/ctis-public/view/2024-517406-29-00